EU clinical trial 2025-521829-32-00: A study to examine the effects of oral NTX-1955 on the brain in healthy adults.
Protocol code: NTX-1955-101
Sponsor: Newleos Therapeutics Inc. (Pharmaceutical company). Phase: Human Pharmacology (Phase I)- Other. Countries: Netherlands (ended).
Therapeutic area(s): Psychiatry and Psychology [F] - Mental Disorders [F03]
Gender: Female, Male. Age: 18-64 years. Enrolment: 18.
Status: Ended. Start date (EU): 2025-06-24. End date (EU): 2025-12-22. Decision date: 2025-06-24. Results received: No. Last updated: 2025-09-16.

Condition(s): Generalized Anxiety Disorder (GAD)

Source: https://euclinicaltrials.eu/ctis-public/view/2025-521829-32-00